EU clinical trial 2025-521762-99-00: Thrombolysis with Tenecteplase for Acute Ischemic Stroke in Patients taking Direct Oral Anticoagulants – a multicentre randomised placebo-controlled clinical trial
Protocol code: PASSION
Sponsor: University Medical Center Hamburg-Eppendorf (Hospital/Clinic/Other health care facility). Phase: Therapeutic confirmatory (Phase III). Countries: Germany (ongoing, recruiting).
Therapeutic area(s): Diseases [C] - Cardiovascular Diseases [C14]
Gender: Female, Male. Age: 18-64 years, 65+ years. Enrolment: 668.
Status: Ongoing, recruiting. Start date (EU): 2026-03-09. Decision date: 2025-12-16. Results received: No. Last updated: 2026-06-08.

Condition(s): acute ischemic stroke
Product: Placebo to Metalyse®, Metalyse 5 000 units (25 mg) powder for solution for injection

Primary endpoint: Functional outcome (modified Rankin Scale, mRS) 90 days after randomisation
Endpoint(s): Efficacy Endpoint: Nondisabled (mRS score ≤ 1) functional outcome after 90 days, Efficacy Endpoint: Independent (mRS score ≤ 2) functional outcome after 90 days, Efficacy Endpoint: Early neurological deficit (National Institutes of Health stroke scale) after 24 hours, Efficacy Endpoint: Health-related quality of life (PROMIS®-10) after 90 days, Efficacy Endpoint: Cognitive impairment (Montreal Cognitive Assessment) after 90 days, Safety Endpoint: Any intracranial haemorrhage within 36 hours, Safety Endpoint: Symptomatic intracranial haemorrhage within 36 hours (mSITS-MOST), Safety Endpoint: Fatal intracranial haemorrhage within 30 days, Safety Endpoint: Major haemorrhage (ISTH) within 72 hours, Safety Endpoint: Orolingual angioedema within 4 hours, Safety Endpoint: Death or dependency (mRS score 4–6) after 90 days, Safety Endpoint: All-cause mortality after 90 days, Safety Endpoint: Time to death right-censored at 90 days

Source: https://euclinicaltrials.eu/ctis-public/view/2025-521762-99-00